EU clinical trial 2023-509044-96-00: Irinotecan-based triplet (FOLFOXIRI) as perioperative treatment in resectable gastric and gastroesophageal junction adenocarcinoma.
Sponsor: Region Skane (Hospital/Clinic/Other health care facility). Phase: Therapeutic exploratory (Phase II). Countries: Norway (ongoing, recruitment ended), Sweden (ongoing, recruitment ended).
Therapeutic area(s): Diseases [C] - Neoplasms [C04]
Gender: Female, Male. Age: 18-64 years, 65+ years. Enrolment: 57.
Status: Ongoing, recruitment ended. Start date (EU): 2018-12-21. Decision date: 2024-05-21. Results received: No. Last updated: 2024-05-22.
Decision dates by country: SE: 2024-05-22, NO: 2024-05-21

Condition(s): Resectabel gastric and gastroesophageal junction adenocarcinoma
Product: FLUOROURACIL, OXALIPLATIN, CALCIUM FOLINATE, IRINOTECAN HYDROCHLORIDE TRIHYDRATE

Primary endpoint: Histopathological response rate within 30 days post surgery
Endpoint(s): Microscopically radical resection rate: Within 30 Days post surgery, Treatment completion rate: After completion of neoadjuvant and adjuvant chemotherapy., Disease free survival and overall survival: At follow up 12, 18, 24, 30, 36, 48 and 60 months from registration., Toxicity: Continuous during study treatment and then another 4 weeks, Complications: Within 30 days from surgery

Source: https://euclinicaltrials.eu/ctis-public/view/2023-509044-96-00